EU clinical trial 2023-504684-16-00: A Phase 3, Randomized, Double-Blind, Placebo-Controlled, Multicenter Study to Evaluate the Efficacy and Safety of Tafasitamab Plus Lenalidomide in Addition to Rituximab Versus Lenalidomide in Addition to Rituximab in Patients With Relapsed/Refractory (R/R) Follicular Lymphoma Grade 1 to 3a or R/R Marginal Zone Lymphoma
Protocol code: INCMOR0208-301
Sponsor: Incyte Corp. (Pharmaceutical company). Phase: Therapeutic confirmatory (Phase III). Countries: Czechia (ongoing, recruitment ended), Norway (ongoing, recruitment ended), Netherlands (ongoing, recruitment ended), Sweden (ongoing, recruitment ended), France (ongoing, recruitment ended), Belgium (ongoing, recruitment ended), Ireland (ongoing, recruitment ended), Hungary (ongoing, recruitment ended), Denmark (ongoing, recruitment ended), Spain (ongoing, recruitment ended), Poland (ongoing, recruitment ended), Austria (ongoing, recruitment ended), Italy (ongoing, recruitment ended), Germany (ongoing, recruitment ended), Finland (ongoing, recruitment ended), Greece (ongoing, recruitment ended).
Therapeutic area(s): Diseases [C] - Neoplasms [C04]
Gender: Female, Male. Age: 18-64 years, 65+ years. Enrolment: 345.
Status: Ongoing, recruitment ended. Start date (EU): 2021-06-05. Decision date: 2024-01-15. Results received: No. Last updated: 2026-06-08.
Decision dates by country: AT: 2024-01-22, DK: 2024-01-22, IE: 2024-01-15, FI: 2024-01-19, NL: 2024-01-16, SE: 2024-01-16, CZ: 2024-01-17, NO: 2024-01-16, HU: 2024-01-19, PL: 2024-02-23, IT: 2024-01-19, BE: 2024-01-15, FR: 2024-01-15, ES: 2024-01-18, GR: 2024-02-23, DE: 2024-01-18

Condition(s): follicular lymphoma (FL) and marginal zone lymphoma (MZL)
Product: Revlimid 15 mg hard capsules, Revlimid 5 mg hard capsules, Revlimid 10 mg hard capsules, Revlimid 5 mg hard capsules, Zelvina 10 mg hard capsules, Revlimid 15 mg hard capsules, 0.9% saline solution for infusion. The placebo (250 mL infusion container with 0.9% (w/v) sodium chloride for injection) is being sourced locally from commercial market and delivered to an unblinded pharmacy., MINJUVI 200 mg powder for concentrate for solution for infusion, Zelvina 5 mg hard capsules, Zelvina 15 mg hard capsules, Zelvina 20 mg hard capsules, Revlimid 10 mg hard capsules, Revlimid 20 mg hard capsules, Revlimid 20 mg hard capsules, Truxima 100 mg concentrate for solution for infusion

Primary endpoint: PFS by investigator (INV) assessment in the FL population, using Lugano 2014 criteria (Cheson et al 2014). PFS is defined as the time from randomization to first documented disease progression, or death from any cause, whichever occurs first.
Endpoint(s): * PFS by INV assessment in the overall population (FL and MZL populations). * PET-CR rate by INV in the FDG-avid FL population, defined as a complete metabolic response at any time after start of treatment. *OS in the FL population.

Source: https://euclinicaltrials.eu/ctis-public/view/2023-504684-16-00